EU clinical trial 2024-519788-16-00: An open label phase II platform modular study exploring the efficacy and safety of the Valemetostat (EZH1/2 inhibitor) in patients with selected solid tumors (EZHiSWITCH)
Protocol code: 2024/3993 EZHiSWITCH
Sponsor: Institut Gustave Roussy (Hospital/Clinic/Other health care facility). Phase: Therapeutic exploratory (Phase II). Countries: France (ongoing, recruiting).
Therapeutic area(s): Diseases [C] - Neoplasms [C04]
Gender: Female, Male. Age: 18-64 years, 65+ years. Enrolment: 600.
Status: Ongoing, recruiting. Start date (EU): 2026-03-05. Decision date: 2025-12-09. Results received: No. Last updated: 2025-12-09.

Condition(s): Adult patients with histologically/cytologically confirmed progressive metastatic or recurrent solid tumor, who have selected chromatin remodeling deficiency in at least one of the following genes: SMARCB1, SMARCA4, SMARCA2, SMARCC1, SMARCC2, ARID1A, ARID1B, PBRM1, BAP1and other SWI/SNF sub-units; or molecularly (Wildtype) and phenotypically-selected Clear cell endometrial or ovarian carcinoma cancers.
Product: Valemetostat Tosylate, Valemetostat Tosylate

Primary endpoint: Overall Response Rate at 24 weeks, defined as the proportion of patients with a confirmed best overall response of either CR or PR according to RECISTv1.1 (for all patients, except prostate), mRECIST v1.1 (mesothelioma), RECIST1.1/PCWG3 (prostate) and Choi Criteria (sarcoma) at 24 weeks
Endpoint(s): Disease Control Rate at 24 weeks, Duration Of Response, Best Overall Response Rate, Percentage of change from baseline in tumor size at 24 weeks, Tumor Growth Rate (G-score), PFS ratio on valemetostat (PFS pre-treatment / PFS on-treatment at 24W and 12 months), Overall survival (OS), Incidence and severity of AEs (including SAE and AESIs) according to the NCI CTCAE v5.0, Changes in clinical laboratory parameters, when clinically significant, Incidence of dose interruptions, dose modifications and discontinuations to AEs, Dose-intensity, incidence of SAEs and AESIs per cycle, Correlation between SWI/SNF defect and primary and/or secondary endpoints, Correlation between molecular profiling and/or endpoints, Correlation between modifications of epigenetic landscape on treatment and primary and/or secondary endpoints, Correlation between SWI/SNF defects and immune-related biomarkers on tumor and liquid biopsies o At baseline o On treatment, Comparison of the correlations defined above according to the histotype, EORTC-QLQ30 QoL questionnaire and Patients Reported Outcomes, PRO CTCAE composite score of selected events, Patient reported Anxiety and Depression as measured by the Hospital Anxiety and Depression Scale (HADS)., Qualitative evaluation of patient experience regarding themes around the care journey, expectations and uncertainty whilst undergoing therapy through in-person or virtual qualitative interviews conducted before disease re-evaluation, Physiological parameters (Heartbeat, mobility, SpO2, and sleep cycle) captured by wearable device

Source: https://euclinicaltrials.eu/ctis-public/view/2024-519788-16-00